EU clinical trial 2022-501927-25-00: A Single-Arm, Open-Label, Phase 1/2 Study Evaluating the Safety, Efficacy, and Cellular Kinetics/Pharmacodynamics of ALLO-501A, an Anti-CD19 Allogeneic CAR T Cell Therapy, and ALLO-647, an Anti-CD52 Monoclonal Antibody, in Subjects with Relapsed/Refractory Large B Cell Lymphoma (LBCL).
Protocol code: ALLO-501A-201
Sponsor: Allogene Therapeutics Inc. (Pharmaceutical company). Phase: Therapeutic exploratory (Phase II). Countries: Italy (ended), Spain (ended).
Therapeutic area(s): Diseases [C] - Neoplasms [C04]; Diseases [C] - Hemic and Lymphatic Diseases [C15]; Diseases [C] - Immune System Diseases [C20]
Gender: Female, Male. Age: 18-64 years, 65+ years. Enrolment: 35.
Status: Ended. Start date (EU): 2023-09-29. End date (EU): 2024-01-12. Decision date: 2023-07-11. Results received: No. Last updated: 2024-01-15.
Decision dates by country: IT: 2023-07-11, ES: 2023-07-13

Condition(s): Large B-Cell Lymphoma (LBCL)
Product: Phenergan 25mg/ml Solution for Injection, Solu-Cortef Powder for Solution for Injection or Infusion 100 mg, ALLO-647, PREVYMIS 240 mg film-coated tablets, Cyclophosphamide 500 mg Powder for Solution for Injection or Infusion, RoActemra 20 mg/mL concentrate for solution for infusion, Fludarabine phosphate 25 mg/ml Concentrate for Solution for Injection or Infusion, Loratadine 10 mg Tablets, Paracetamol 10 mg/ml solution for infusion, Quamatel 20 mg por és oldószer oldatos injekcióhoz, ALLO-501A, PREVYMIS 480 mg film-coated tablets

Primary endpoint: Phase 2 Primary Endpoints: Efficacy, ORR, defined as assessment of CR or PR, assessed using the Lugano classification criteria 2014; Cheson et al, 2014) by IRC.
Endpoint(s): Secondary Endpoints (Phase 1 and 2): Efficacy ALLO-501A: DOR is defined only for subjects who experience an objective response and is the time from the first objective response to disease progression per (Cheson et al, 2014) and per IRC (Phase 2 only) and per investigator assessment) or death, whichever comes first., Secondary Endpoints (Phase 1 and 2): Efficacy ALLO-501A: ORR per investigator assessment, Secondary Endpoints (Phase 1 and 2): Efficacy ALLO-501A: Best overall response (CR, PR, SD, PD) (per IRC (Phase 2 only) and per investigator assessment), Secondary Endpoints (Phase 1 and 2): Efficacy ALLO-501A: PFS, defined as time from the enrollment date to progression, relapse, or death (per IRC (Phase 2 only) and per investigator assessment), Secondary Endpoints (Phase 1 and 2): Efficacy ALLO-501A: TTR, defined as the time from the enrollment date to the first observed response (per IRC (Phase 2 only) and per investigator assessment), Secondary Endpoints (Phase 1 and 2): Efficacy ALLO-501A: OS, defined as the time from the enrollment date to death, Secondary Endpoints (Phase 1 and 2): Pharmacokinetic and Pharmacodynamic for ALLO-501A and ALLO-647: Depth of lymphodepletion, as assessed by lymphocyte count, Secondary Endpoints (Phase 1 and 2): Pharmacokinetic and Pharmacodynamic for ALLO-501A and ALLO-647: Duration of lymphodepletion, as assessed by lymphocyte recovery, Secondary Endpoints (Phase 1 and 2): Pharmacokinetic and Pharmacodynamic for ALLO-501A and ALLO-647: PK concentrations will be used in a population PK model, Secondary Endpoints (Phase 1 and 2): Pharmacokinetic and Pharmacodynamic for ALLO-501A and ALLO-647: ALLO-501A expansion and persistence, eg, Cmax and AUC, Secondary Endpoints (Phase 1 and 2): Pharmacokinetic and Pharmacodynamic for ALLO-501A and ALLO-647: Pharmacodynamics will be evaluated on host T cell counts., Secondary Endpoints (Phase 1 and 2): Pharmacokinetic and Pharmacodynamic for ALLO-501A and ALLO-647: The incidence of ADA against ALLO-501A scFv and/or TALEN®, Secondary Endpoints (Phase 1 and 2): Pharmacokinetic and Pharmacodynamic for ALLO-501A and ALLO-647: Incidence of ADA against ALLO-647, Secondary Endpoints (Phase 1 and 2): Safety ALLO-501A: AEs as characterized by preferred term, frequency, severity timing, seriousness, and relationship to ALLO-501A, The incidence and severity of CRS, GVHD, infections, cytopenias, and neurotoxicity, Secondary Endpoints (Phase 1 and 2): Safety ALLO-647 AEs as characterized by preferred term, frequency, severity, timing, seriousness, and relationship to ALLO-647, The incidence of infusion-related reactions, cytopenias, and infections, Secondary Endpoints (Phase 1 and 2): Safety ALLO-647: The incidence and severity of clinically significant laboratory toxicities

Source: https://euclinicaltrials.eu/ctis-public/view/2022-501927-25-00